EU clinical trial 2024-513997-23-00: Evaluation of 68GaNOTA-Anti-HER2 VHH1 uptake in brain metastasis of cancer patients
Sponsor: Universitair Ziekenhuis Brussel (Hospital/Clinic/Other health care facility). Phase: Therapeutic exploratory (Phase II). Countries: Belgium (ended).
Therapeutic area(s): Not possible to specify
Gender: Female, Male. Age: 18-64 years, 65+ years. Enrolment: 30.
Status: Ended. Start date (EU): 2017-10-16. End date (EU): 2025-10-14. Decision date: 2024-07-30. Results received: No. Last updated: 2024-07-30.

Condition(s): Cancer patients with brain metastasis
Product: 68Ga-NOTA-anti-HER2 VHH1

Primary endpoint: The tumor targeting potential in brain metastasis will be visually scored as positive or negative by an experienced nuclear medicine physician, unaware of the HER2-status, The tumor targeting potential in brain metastasis will be assessed quantitatively using Standard Uptake Values (SUV) by an experienced nuclear medicine physician, unaware of the HER2-status.
Endpoint(s): If available, uptake will be evaluated during and after treatment and compared to baseline values. Results will be compared to information of patient's disease course.

Source: https://euclinicaltrials.eu/ctis-public/view/2024-513997-23-00